EU clinical trial 2022-501514-56-00: Comparative Bioavailability and Bioequivalence of Testosterone Transdermal Gel Versus Testogel® Dosiergel 16.2 mg/g gel: A Single-Dose, Open-Label, Randomized, Full Replicate, Four-Period Crossover Study in Healthy Female Subjects Under Fasting Conditions.
Protocol code: BLCL-TES-EU-01
Sponsor: Laboratorios Leon Farma S.A. (Pharmaceutical company). Phase: Human Pharmacology (Phase I)- Bioequivalence Study. Countries: Portugal (ended).
Therapeutic area(s): Diseases [C] - Hormonal diseases [C19]
Gender: Female. Age: 18-64 years, 65+ years. Enrolment: 48.
Status: Ended. Start date (EU): 2023-05-02. End date (EU): 2023-07-31. Decision date: 2023-01-30. Results received: Yes. Last updated: 2023-05-08.

Condition(s): Male hypogonadism
Product: Testogel Dosiergel 16,2 mg/g Gel, Testosterone 1.62%; transdermal gel metered-dose pump

Primary endpoint: Cmax and AUC0-t estimated from baseline corrected testosterone will be the primary pharmacokinetic parameters, AUC0-∞ will be the secondary pharmacokinetic parameter.
Endpoint(s): Safety assessments will include physical examination, detailed skin examination, vital signs, 12-lead ECG, clinical laboratory tests, skin irritation/tolerability assessments and adverse events (AEs) monitoring.

Source: https://euclinicaltrials.eu/ctis-public/view/2022-501514-56-00